EU clinical trial 2023-504052-99-00: Single Dose Crossover Comparative Bioavailability and Food Effect Study of Celecoxib 10 mg/1 mL Oral Suspension versus Celebrex®️ (celecoxib) 200 mg Capsules Following the Administration of a 200 mg Dose in Healthy Adult Volunteers / Fasting and Fed State.
Protocol code: 915/22
Sponsor: Codadose Inc. (Pharmaceutical company). Phase: Human Pharmacology (Phase I)- Bioequivalence Study. Countries: Czechia (ended).
Therapeutic area(s): Diseases [C] - Musculoskeletal Diseases [C05]; Phenomena and Processes [G] - Musculoskeletal and Neural Physiological Phenomena [G11]; Not possible to specify
Gender: Female, Male. Age: 18-64 years. Enrolment: 54.
Status: Ended. Start date (EU): 2023-07-31. End date (EU): 2023-09-04. Decision date: 2023-06-28. Results received: No. Last updated: 2023-07-10.

Condition(s): Musculoskeletal and connective tissue disorders, Dysmenorrhea, Acute pain
Product: Celebrex® (celecoxib) Capsules, 200 mg, Heparin Léčiva Injekční roztok, Celecoxib Oral Suspension (10 mg/1 mL)

Primary endpoint: AUC (0-t), AUC (0-∞), and Cmax for celecoxib
Endpoint(s): AUCres, tmax, t1/2, and λz for celecoxib

Source: https://euclinicaltrials.eu/ctis-public/view/2023-504052-99-00